EU clinical trial 2023-504273-21-00: An open label, multicenter, phase II study of Elranatamab as single agent for the treatment of relapsed or refractory myeloma in patients previously exposed to three-drug classes
Sponsor: Pethema Fundacion (Patient organisation/association). Phase: Therapeutic exploratory (Phase II). Countries: Spain (ongoing, recruitment ended).
Therapeutic area(s): Diseases [C] - Neoplasms [C04]; Diseases [C] - Hemic and Lymphatic Diseases [C15]
Gender: Female, Male. Age: 18-64 years, 65+ years. Enrolment: 50.
Status: Ongoing, recruitment ended. Start date (EU): 2023-10-31. Decision date: 2023-09-04. Results received: No. Last updated: 2026-03-02.

Condition(s): Multiple Myeloma
Product: ELRANATAMAB

Primary endpoint: A participant is considered to have completed the study if he or she is followed until disease progression, withdrawal of consent, loss to follow up, death or end of study.

Source: https://euclinicaltrials.eu/ctis-public/view/2023-504273-21-00